EU clinical trial 2023-504807-94-00: A study of STX-478 alone and in combination with other anticancer drugs in participants with advanced solid tumors.
Protocol code: STX-478-101
Sponsor: Scorpion Therapeutics Inc. (Pharmaceutical company). Phase: Phase I and Phase II (Integrated)- First administration to humans. Countries: Spain (ongoing, recruiting), Italy (ongoing, recruiting), France (ongoing, recruiting), Netherlands (ongoing, recruiting), Ireland (ongoing, recruiting), Belgium (ongoing, recruiting), Germany (authorised, recruitment pending).
Therapeutic area(s): Diseases [C] - Neoplasms [C04]
Gender: Female, Male. Age: 18-64 years, 65+ years. Enrolment: 376.
Start date (EU): 2023-12-26. Decision date: 2023-11-20. Results received: No. Last updated: 2026-08-06.
Decision dates by country: NL: 2025-04-22, IE: 2025-04-25, DE: 2026-02-03, ES: 2023-11-20, IT: 2023-11-22, BE: 2026-01-05, FR: 2023-11-27

Condition(s): Breast Cancer; Advanced solid tumors including but not limited to gynecologic Cancer; Head and Neck Squamous Cell Carcinoma

Source: https://euclinicaltrials.eu/ctis-public/view/2023-504807-94-00